EU clinical trial 2022-500413-11-00: A Phase 3, Randomized, Placebo-Controlled Clinical Study to Evaluate the Safety and Efficacy of Stereotactic Body Radiotherapy (SBRT) with or without Pembrolizumab (MK-3475) in Participants with Unresected Stage I or II Non-Small Cell Lung Cancer (NSCLC) (KEYNOTE-867)
Protocol code: MK3475-867
Sponsor: Merck Sharp & Dohme Corp. (Pharmaceutical company). Phase: Therapeutic confirmatory (Phase III). Countries: Germany (ended), Netherlands (ended), Norway (ended), Spain (ended), Hungary (ended), Italy (ended), France (ended), Austria (ended), Poland (ended), Romania (ended).
Therapeutic area(s): Diseases [C] - Neoplasms [C04]
Gender: Female, Male. Age: 18-64 years, 65+ years. Enrolment: 243.
Status: Ended. Start date (EU): 2019-06-17. End date (EU): 2024-08-29. End date: 2025-01-20. Decision date: 2023-01-27. Results received: Yes. Last updated: 2024-07-17.
Decision dates by country: NO: 2023-01-30, NL: 2023-02-10, AT: 2023-02-20, DE: 2023-01-27, HU: 2023-01-27, PL: 2023-03-27, ES: 2023-02-09, RO: 2023-09-18, FR: 2023-01-27, IT: 2023-01-27

Condition(s): Unresected Stage I or II Non-Small Cell Lung Cancer (NSCLC)
Product: KEYTRUDA 25 mg/mL concentrate for solution for infusion, Placebo to Keytruda-Normal Saline Solution

Primary endpoint: Event-Free Survival (EFS)
Endpoint(s): Overall Survival (OS), Time to Death or Distant Metastases (TDDM), Number of Participants Who Experience an Adverse Event (AE), Number of Participants Who Discontinue Study Treatment Due to an AE, Change from Baseline in European Organization for Research and Treatment of Cancer Quality of Life Questionnaire-Core 30 (EORTC QLQ-C30) Global Health Status/Quality of Life (Items 29 and 30) Score, Change from Baseline in European Organization for Research and Treatment of Cancer Quality of Life Questionnaire-Lung Cancer Module 13 (EORTC QLQ-LC13) Cough (Item 1) Score, Change from Baseline in European Organization for Research and Treatment of Cancer Quality of Life Questionnaire-Lung Cancer Module 13 (EORTC QLQ-LC13) Chest Pain (Item 10) Score, Change from Baseline in European Organization for Research and Treatment of Cancer Quality of Life Questionnaire-Core 30 (EORTC QLQ-C30) Dyspnea (Item 8) Score, Change from Baseline in European Organization for Research and Treatment of Cancer Quality of Life Questionnaire-C30 (EORTC QLQ-C30) Physical Functioning (Items 1-5) Score

Source: https://euclinicaltrials.eu/ctis-public/view/2022-500413-11-00